EU clinical trial 2024-520205-39-00: Efficacy of early continuous infusion of hypertonic saline solution on the neurological outcome at 6 months in traumatic brain injured patients. A single-blinded, multicenter, randomized, controlled clinical trial with blinded evaluation of the primary outcome.
Protocol code: RC24_0543
Sponsor: Centre Hospitalier Universitaire De Nantes (Hospital/Clinic/Other health care facility). Phase: Therapeutic confirmatory (Phase III). Countries: France (ongoing, recruiting).
Therapeutic area(s): Diseases [C] - Nervous System Diseases [C10]
Gender: Female, Male. Age: 0-17 years, 18-64 years, 65+ years. Enrolment: 760.
Status: Ongoing, recruiting. Start date (EU): 2026-04-21. Decision date: 2025-08-22. Results received: No. Last updated: 2026-01-15.

Condition(s): Traumatic brain injury
Product: SODIUM CHLORIDE, SODIUM CHLORIDE, MANNITOL

Primary endpoint: The co-primary hierarchic endpoints will be survival at 3 months and moderate to no dependency in activities in daily living at 6 months, which will be assessed centrally by a blinded evaluator.
Endpoint(s): Evolution of natremia, chloremia, and plasma osmolarity (7 days), Therapeutic intensity level during the first 7 days, Survival at 1, 6 and 12 months, EQ-5D-5L at 1, 3, 6 and 12 months (quality-adjusted life year), Residency at 1, 3, 6 and 12 months, G.O.A.T at 1, 3 and 6 months, MOCA, GOS-E at 6 months, Rates severe hypernatremia (Na> 160 mmol/L) at Month 1, Rates of acute kidney injury at Month 1 (KDIGO score 2-3), Safety (thrombotic events, central-pontine myelinolysis), Incremental cost-effectiveness ratio with a one-year time horizon, Single nucleotide polymorphism correlated with the clinical outcome

Source: https://euclinicaltrials.eu/ctis-public/view/2024-520205-39-00